EU clinical trial 2025-520825-19-00: A Phase 3 Multicenter, Randomized, Double-Blind, Placebo Controlled Trial to Evaluate Efficacy and Safety of Mezagitamab (TAK-079) in Study Participants with Primary IgA Nephropathy in Combination with Stable Background Therapy
Protocol code: TAK-079-3001
Sponsor: Takeda Development Center Americas Inc. (Pharmaceutical company). Phase: Therapeutic confirmatory (Phase III). Countries: Spain (ongoing, recruiting), Czechia (ongoing, recruiting), Austria (ongoing, recruiting), Hungary (ongoing, recruiting), Germany (ongoing, recruiting), Norway (ongoing, recruiting), Slovenia (ongoing, recruiting), France (ongoing, recruiting), Sweden (ongoing, recruiting), Netherlands (ongoing, recruiting), Poland (ongoing, recruiting), Italy (ongoing, recruiting).
Therapeutic area(s): Diseases [C] - Immune System Diseases [C20]
Gender: Female, Male. Age: 18-64 years, 65+ years. Enrolment: 138.
Status: Ongoing, recruiting. Start date (EU): 2025-12-16. Decision date: 2025-09-16. Results received: No. Last updated: 2026-07-22.
Decision dates by country: HU: 2025-09-18, FR: 2025-09-22, CZ: 2025-09-17, SI: 2025-09-18, AT: 2025-09-22, SE: 2025-09-16, PL: 2025-09-19, NL: 2025-09-16, DE: 2025-09-17, ES: 2025-09-16, NO: 2025-09-18, IT: 2025-09-16

Condition(s): IgAN is Primary Immunoglobulin A Nephropathy (IgAN) (also known as Berger's disease)
Product: Mezagitamab placebo-matching injection administered SC, Mezagitamab

Primary endpoint: Change from baseline in proteinuria at Week 36 as assessed by a UPCR calculated from a 24-hour urine collection (IA1).
Endpoint(s): 01. Change from baseline in eGFR at Week 52 interim analysis 2 (IA2)., 02. Change from baseline in eGFR at Week 104 final analysis (FA)., 03. eGFR total slope at Week 104 (FA)., 04. Time from baseline to the first occurrence of sustained decline in eGFR of ≥30% from baseline over at least 4 weeks (FA)., 05. Time from baseline to the first occurrence of any of the following outcomes based on the kidney failure composite endpoint: sustained decline in eGFR of ≥30% from baseline over at least 4 weeks; sustained eGFR <15 mL/min/1.73 m2 over at least 4 weeks; initiation of maintenance dialysis defined as dialysis performed for at least 4 weeks; receipt of kidney transplant; or death from kidney failure (FA) (Levin et al. 2020)., 06. Proteinuria levels change from baseline at Week 52 (FA)., 07 Proteinuria levels change from baseline at Week 104 (FA).

Source: https://euclinicaltrials.eu/ctis-public/view/2025-520825-19-00